EU clinical trial 2024-510606-85-00: A Study to find out the safety, tolerability and interaction of drug with body (including the effect of Itraconazole on RO7268489) and also what the body does to RO7268489 after oral intake by healthy participants
Protocol code: BP45248
Sponsor: F. Hoffmann-La Roche AG (Pharmaceutical company). Phase: Human Pharmacology (Phase I)- Other. Countries: Netherlands (ended).
Therapeutic area(s): Not possible to specify
Gender: Female, Male. Age: 18-64 years. Enrolment: 34.
Status: Ended. Start date (EU): 2024-05-10. End date (EU): 2025-06-13. End date: 2025-06-14. Decision date: 2024-05-03. Results received: No. Last updated: 2025-06-24.

Source: https://euclinicaltrials.eu/ctis-public/view/2024-510606-85-00